EU clinical trial 2024-515418-41-00: Randomized, multicenter, open-label study on PREvention of respiratory SEquelae of RSV bronchiolitis in preterm babies (PRESERV)
Protocol code: PRESERV
Sponsor: Azienda Sanitaria Locale Della Provincia Di Biella (Hospital/Clinic/Other health care facility). Phase: Therapeutic confirmatory (Phase III). Countries: Italy (ended).
Therapeutic area(s): Diseases [C] - Respiratory Tract Diseases [C08]
Gender: Female, Male. Age: 0-17 years. Enrolment: 760.
Status: Ended. Start date (EU): 2020-06-12. End date (EU): 2025-05-22. Decision date: 2024-08-07. Results received: Yes. Last updated: 2024-12-02.

Condition(s): Respiratory sincizial (RSV) bronchiolitis
Product: Synagis 50 mg/0.5 ml solution for injection

Primary endpoint: Overall respiratory morbidity (composite primary endpoint), whose definition is: a) LRTIs by any pathogen (including, but not limited to RSV); b) recurrent wheezing (quantified as presence of wheezing days and/or need for use of antiwheezing drugs ) +/- asthma
Endpoint(s): Difference of number of RSV-related hospitalizations due to low respiratory tract infection during the first RSV-season (November 1st- March 31th) between Group A and Group B., Direct costs in terms of difference of health resources used by Group A and Group B respectively and related to: lenght of hospitalizations(days);mechanical ventilation and other support therapies(type, number, duration);Intensive Care Unit admission and lenght of stay(days);outpatient visits(type and number of specialistic visits);drugs(type, dosage and therapy duration);diagnostic tests(type and number).Costs for resources used will be calculated using National Health Service tariffs, Indirect costs in terms of loss of working days for due to child illness

Source: https://euclinicaltrials.eu/ctis-public/view/2024-515418-41-00